EU clinical trial 2026-526324-48-00: Exploratory study of the performance of dynamic PET-CT acquisition to predict 6-month morphological response in patients with hepatocellular carcinoma treated with selective internal radiotherapy
Protocol code: DYNAMIC_PET_SIRT
Sponsor: Centr Georges Francois Leclerc (Hospital/Clinic/Other health care facility). Phase: Phase I and Phase II (Integrated)- Other. Countries: France (authorised, recruitment pending).
Therapeutic area(s): Diseases [C] - Neoplasms [C04]
Gender: Female, Male. Age: 18-64 years, 65+ years. Enrolment: 30.
Status: Authorised, recruitment pending. Decision date: 2026-06-22. Results received: No. Last updated: 2026-06-22.

Condition(s): HCC – Hepatocellular Carcinoma

Source: https://euclinicaltrials.eu/ctis-public/view/2026-526324-48-00